EU clinical trial 2022-502951-77-00: A study to evaluate the effect of multiple doses of carbamazepine on how long aticaprant (JNJ-67953964) stays in the body (pharmacokinetics) in healthy adults
Sponsor: Janssen - Cilag International (Pharmaceutical company). Phase: Human Pharmacology (Phase I)- Other. Countries: Belgium (ended).
Therapeutic area(s): Psychiatry and Psychology [F] - Mental Disorders [F03]
Gender: Female, Male. Age: 18-64 years. Enrolment: 20.
Status: Ended. Start date (EU): 2023-05-05. End date (EU): 2023-09-11. Decision date: 2023-03-13. Results received: No. Last updated: 2023-05-18.

Condition(s): Healthy Adult Participants

Source: https://euclinicaltrials.eu/ctis-public/view/2022-502951-77-00